EU clinical trial 2022-502975-45-00: Randomized, Controlled, Open-label, Phase III Study of Lurbinectedin in Combination with Doxorubicin versus Doxorubicin Alone as First-line Treatment in Patients with Metastatic Leiomyosarcoma (SaLuDo)
Protocol code: PM1183-C-010-22
Sponsor: Pharma Mar S.A. (Pharmaceutical company). Phase: Therapeutic confirmatory (Phase III). Countries: Italy (ongoing, recruitment ended), France (ongoing, recruitment ended), Spain (ongoing, recruitment ended), Belgium (ongoing, recruitment ended), Austria (ongoing, recruitment ended), Germany (ongoing, recruitment ended), Portugal (ongoing, recruitment ended), Netherlands (ongoing, recruitment ended), Poland (ongoing, recruitment ended).
Therapeutic area(s): Diseases [C] - Neoplasms [C04]
Gender: Female, Male. Age: 18-64 years, 65+ years. Enrolment: 345.
Status: Ongoing, recruitment ended. Start date (EU): 2023-12-12. Decision date: 2023-10-24. Results received: No. Last updated: 2026-06-25.
Decision dates by country: NL: 2025-03-03, FR: 2023-11-23, AT: 2024-01-04, IT: 2023-10-24, PL: 2025-03-02, BE: 2023-12-18, PT: 2025-01-13, DE: 2024-01-03, ES: 2023-12-11

Condition(s): Metastatic leiomyosarcoma
Product: DOXORUBICIN HYDROCHLORIDE, DEXAMETHASONE SODIUM PHOSPHATE, lurbinectedin, ONDANSETRON HYDROCHLORIDE DIHYDRATE, FILGRASTIM, FILGRASTIM, DOXORUBICIN HYDROCHLORIDE

Primary endpoint: 1. PFS by IRC is defined as the time from the date of randomization to the date of documented progression per RECIST v.1.1 or death (regardless of the cause of death)., 2. If the patient is lost to follow-up before disease progression (PD), PFS will be censored at the date of last tumor assessment., 3. If the patient receives further antitumor therapy before PD, PFS will be censored at the last tumor assessment performed before the start of new antitumor therapy. In the event of a patient with at least two missing visits before PD, PFS will be censored at the date of the last prior tumor assessment.
Endpoint(s): 2A PFS by IA is defined as the time from the date of registration to the date of documented progression per RECIST v.1.1 or death (regardless of the cause of death)., 3. ORR by IRC and IA is defined as the percentage of patients with a response, either complete (CR) or partial (PR), according to the RECIST v.1.1., 4. Duration of response (DoR) by IRC and IA will be calculated from the date of first documentation of response per RECIST v.1.1 (CR or PR, whichever comes first) to the date of documented PD or death. The censoring rules defined for PFS will be used for DoR., 5. Clinical Benefit Rate (CBR) by IRC and IA is defined as objective response plus stable disease (SD) ≥ 6 months according to the RECIST v.1.1., 6. PFS on next-line therapy (PFS2) by IA is defined as the time from the date of randomization to the date of progression on next line treatment or death (regardless of the cause of death), whichever occurs first. In case of no event, follow-up of the patient will be censored at the date of last news., 1. Key secondary endpoint: • Overall survival (OS) will be calculated from the date of randomization to the date of death (death event) or last contact (in this case, survival will be censored on that date).Other Secondary Endpoints:, 7. Treatment safety profile: AEs, serious adverse events (SAEs) and laboratory abnormalities will be coded by the Medical Dictionary for Regulatory Activities (MedDRA), graded according to the NCI-CTCAE v.5 and analyzed. Dose delays or reductions required due to treatment-related AEs, and reasons for treatment discontinuations will also be assessed., 8. Patient-reported outcomes (PRO): To measure the quality of life of patients, the EORTC QLQ-C30 questionnaire will be analyzed., 9 Subgroup analyses: Subgroup analyses of efficacy and safety profiles in the Experimental arms and the Control arm will be performed., 10. Plasma PK of lurbinectedin, doxorubicin and its metabolite doxorubicinol will be evaluated using a sparse sampling scheme. Details will be given in a population PK analysis plan, and results will be presented in a separate report., 11. PK/PD correlation: Population PK correlations of exposure to lurbinectedin, doxorubicin and its metabolite doxorubicinol with safety will be explored. Details will be given in specific population PK/PD analysis plans, and results will be presented in separate reports., 2B If the patient is lost to follow-up before PD, PFS will be censored at the date of last tumor assessment. If the patient receives further antitumor therapy before PD, PFS will be censored at the last tumor assessment performed before the start of new antitumor therapy., 12A Pharmacogenomics (PGx): The mutational status and the expression levels of potential predictive factors of response and/or resistance to lurbinectedin and doxorubicin treatment, or to doxorubicin alone will be analyzed from available tumor and/or blood samples obtained before, during and at the end of treatment (either during the EOT visit, or as soon as possible during the follow-up period)., 12B Their correlation with the clinical response and outcome after treatment will be assessed. This analysis will be performed in those patients who signed the ICF for the PGx substudy., 2C In the event of a patient with at least two missing visits before PD, PFS will be censored at the date of the last prior tumor assessment otherwise

Source: https://euclinicaltrials.eu/ctis-public/view/2022-502975-45-00